EU clinical trial 2024-513814-37-00: Efficiency of everolimus for the treatment of kidney transplanted patients presenting a missing self-induced NK-mediated rejection (STARR)
Protocol code: 69HCL17_0706
Sponsor: Hospices Civils De Lyon (Hospital/Clinic/Other health care facility). Phase: Therapeutic use (Phase IV). Countries: France (ongoing, recruiting).
Therapeutic area(s): Diseases [C] - Nutritional and Metabolic Diseases [C18]
Gender: Female, Male. Age: 18-64 years, 65+ years. Enrolment: 20.
Status: Ongoing, recruiting. Start date (EU): 2020-12-03. Decision date: 2024-09-30. Results received: No. Last updated: 2024-09-30.

Condition(s): Renal Transplantation
Product: CERTICAN 0,25 mg, comprimé dispersible, CERTICAN 0,75 mg, comprimé, CERTICAN 0,1 mg, comprimé dispersible, CERTICAN 0,5 mg, comprimé, CERTICAN 0,25 mg, comprimé

Primary endpoint: Relative variation in Glomerular Filtration Rate (GFR) estimated by the CKD-EPI method between D-15 and M6 after starting everolimus.
Endpoint(s): Histological: variation in the microvascular inflammation score (g+cpt) and chronic glomerular (cg) and vascular (cv) lesions determined according to the Banff 2013 classification between D-15 and M6, Biological: variation in the degree of in vitro activability of NK between D0 and M6, Clinical: relative variation in the proteinuria/creatininuria ratio between D-15 and M6

Source: https://euclinicaltrials.eu/ctis-public/view/2024-513814-37-00